EU clinical trial 2024-511184-28-00: A Phase 2a, Randomized, Placebo-Controlled, Double Blind Multiple Ascending Dose Study in Patients with Cystic Fibrosis Carrying the 3849 +10 Kb C->T Mutation to Evaluate the Safety, Tolerability, Pharmacokinetics, and Preliminary Efficacy of SPL84
Protocol code: SPL84-002
Sponsor: Splisense Ltd. (Pharmaceutical company). Phase: Therapeutic exploratory (Phase II). Countries: France (temporarily halted), Germany (temporarily halted), Hungary (ended), Slovakia (ended), Czechia (ended), Spain (temporarily halted), Italy (temporarily halted), Poland (ended), Lithuania (ended), Netherlands (temporarily halted).
Therapeutic area(s): Diseases [C] - Respiratory Tract Diseases [C08]
Gender: Female, Male. Age: 18-64 years, 65+ years. Enrolment: 16.
Start date (EU): 2024-10-23. Decision date: 2024-08-20. Results received: No. Last updated: 2025-08-26.
Decision dates by country: FR: 2024-08-22, DE: 2024-08-21, HU: 2024-08-26, ES: 2024-08-20, CZ: 2024-08-20, LT: 2024-08-22, SK: 2024-08-22, PL: 2024-08-26, NL: 2024-08-23, IT: 2024-08-20

Condition(s): Cystic fibrosis
Product: Placebo solution for inhalation

Primary endpoint: Incidence, nature, and severity of adverse events (AEs), AEs of Special Interest (AESIs) and serious adverse events (SAEs), Changes from baseline in vital signs, clinical laboratory values, electrocardiogram (ECG), physical examination, sputum microbiology, and pulmonary function., Immunogenicity
Endpoint(s): Characterize the PK parameters based on concentration in plasma, Measure the concentrations of SPL84 in urine, Spirometry: − Forced expiratory volume in 1 second (FEV1); − Forced vital capacity (FVC); − Forced mid-expiratory flow (FEF25-75)., Cystic Fibrosis Questionnaire-Revised Respiratory Symptom Score (CFQ-R RSS), Body weight, Change in antibiotic treatment

Source: https://euclinicaltrials.eu/ctis-public/view/2024-511184-28-00